EU clinical trial 2024-514505-64-01: Acupuncture or Metformin for Insulin Resistance in Women with Polycystic Ovary Syndrome: A Randomized Controlled Trial
Protocol code: PIAII
Sponsor: Karolinska Institutet (Educational Institution). Phase: Phase III and phase IV (Integrated). Countries: Sweden (ongoing, recruiting).
Therapeutic area(s): Diseases [C] - Hormonal diseases [C19]; Diseases [C] - Female Urogenital Diseases and Pregnancy Complications [C13]
Gender: Female. Age: 18-64 years. Enrolment: 353.
Status: Ongoing, recruiting. Start date (EU): 2024-10-18. Decision date: 2024-10-17. Results received: No. Last updated: 2024-10-17.

Condition(s): Polycystic ovary syndrome
Product: Metformin Actavis 500 mg filmdragerad tablett

Primary endpoint: Changes in insulin sensitivity after 16 weeks of intervention as measured by HOMA-IR, by the insulin response to glucose assessed by calculating the area under the curve (AUCinsulin) during the oral glucose tolerance test (OGTT), and by glucose regulation (assessed by analyzing Hba1c levels).
Endpoint(s): After 4 months of intervention: • Changes in secondary metabolic measures, including fasting insulin, c-peptide, glucose, and adipokines, calculation of HOMA-B (i.e. the Islet β-cell function) and the c-peptide index, assessment of the adipokines and lipid profile, body size and proportions and body fat distribution. • Changes in gene expression and DNA methylation profiles related to insulin sensitivity in fat, muscle and endometrial tissue biopsies, and biomarkers in whole blood. • Changes in

Source: https://euclinicaltrials.eu/ctis-public/view/2024-514505-64-01